EU clinical trial 2023-506308-24-00: A Phase 2/3, Randomized, Double-Blind, Controlled Study of XL092 in Combination With Pembrolizumab vs Pembrolizumab in the First-Line Treatment of Subjects With PD-L1 Positive Recurrent or Metastatic Head and Neck Squamous Cell Carcinoma
Protocol code: XL092-305
Sponsor: Exelixis Inc. (Pharmaceutical company). Phase: Phase II and Phase III (Integrated). Countries: Slovakia (ended), France (ongoing, recruitment ended), Romania (ended), Greece (ended), Poland (ongoing, recruitment ended), Bulgaria (ended), Spain (ongoing, recruitment ended), Czechia (ongoing, recruitment ended), Belgium (ongoing, recruitment ended), Hungary (ended), Austria (ended), Italy (ongoing, recruitment ended), Germany (ended).
Therapeutic area(s): Diseases [C] - Neoplasms [C04]
Gender: Female, Male. Age: 18-64 years, 65+ years. Enrolment: 112.
Start date (EU): 2024-05-22. Decision date: 2024-04-16. Results received: No. Last updated: 2026-05-08.
Decision dates by country: HU: 2024-04-19, DE: 2024-04-17, CZ: 2024-04-16, GR: 2024-04-22, IT: 2024-04-18, BE: 2024-04-19, ES: 2024-04-16, AT: 2024-04-22, PL: 2024-04-22, SK: 2024-04-16, FR: 2024-04-16, BG: 2024-04-22, RO: 2024-04-19

Condition(s): Recurrent or metastatic head and neck squamous cell carcinoma
Product: XL092, KEYTRUDA 25 mg/mL concentrate for solution for infusion, XL092

Primary endpoint: PFS per Response Evaluation Criteria in Solid Tumors version 1.1 (RECIST 1.1) by Investigator
Endpoint(s): Incidence and severity of AEs, SAEs, AECIs, Changes in laboratory parameters and vital signs, ORR and DOR per RECIST 1.1 by Investigator, Plasma concentration of zanzalintinib, Correlation measured between pharmacokinetics of zanzalintinib and selected biomarkers with respect to preliminary safety and efficacy outcomes, OS

Source: https://euclinicaltrials.eu/ctis-public/view/2023-506308-24-00